EU clinical trial 2022-502687-20-00: MetroWILMS-1906: Phase 1-2 trial evaluating metronomic chemotherapy in patients with relapsed or refractory Wilms tumor
Protocol code: MetroWilms-1906
Sponsor: Centre Oscar Lambret (Pharmaceutical company). Phase: Therapeutic exploratory (Phase II). Countries: France (ongoing, recruiting).
Therapeutic area(s): Diseases [C] - Neoplasms [C04]
Gender: Female, Male. Age: 0-17 years. Enrolment: 28.
Status: Ongoing, recruiting. Start date (EU): 2022-09-14. Decision date: 2024-05-27. Results received: No. Last updated: 2026-06-29.

Condition(s): Wilms tumor
Product: TEMOZOLOMIDE, IRINOTECAN, ISOTRETINOIN, VINCRISTINE, ETOPOSIDE

Primary endpoint: -Dose limiting toxicity (DLT) over the first cycle (12 weeks, or more in case of temporary discontinuation). - Disease control (complete response, partial response or stable disease) after 2 cycles of treatment, measured by the progression-free survival (PFS), approximately 6 months after inclusion.
Endpoint(s): Progression free survival, computed as the time interval between trial entry and date of progression (according to central review, and using RECIST 1.1) or death from any cause. Patients still alive without evidence of disease progression at the time of their last visit will be censored at that date. We will use similar rules for censoring as for the primary endpoint., Overall survival, computed as the time interval between trial entry and death from any cause. Patients still alive at the time of their last visit will be censored at that date., Health-Related Quality of life (HRQoL) will be assessed using the age-appropriate Kindl® Quality of Life questionnaires (self- and proxy-assessment) (Ravens-Sieberer and Bullinger, 1998), with three time points (baseline and approximately at weeks 7 and 13)., Tumor response based on CT-scan or MRI imaging, using the same method over the whole trial period, and evaluated by central radiological review, using RECIST 1.1 criteria after each cycle of treatment (every 3 months approximately). The early response is based on the evaluation after one cycle. The best response is measured over the whole treatment duration., Adverse events occurring from start of treatment until the end of trial treatment (plus 30 days) will be reported and graded using the NCI-CTCAE v5.0 classification, excluding those unequivocally related to the underlying disease or its progression., The feasibility of evaluated therapy will be assessed in terms of frequency of dose reductions or temporary stops of treatment, summarized by the relative dose intensity for each drug, and reasons for permanent discontinuation.

Source: https://euclinicaltrials.eu/ctis-public/view/2022-502687-20-00